EU clinical trial 2025-524475-23-00: Efficacy of Temocillin compared to standard of care in the Treatment of Neisseria gonorrhoeae Infections: A Multicenter Randomized Controlled Non-Inferiority Trial (TEMtoGo).
Protocol code: APHP251262
Sponsor: Assistance Publique Hopitaux De Paris (Hospital/Clinic/Other health care facility). Phase: Therapeutic confirmatory (Phase III). Countries: France (authorised, recruitment pending).
Therapeutic area(s): Diseases [C] - Bacterial Infections and Mycoses [C01]
Gender: Female, Male. Age: 18-64 years, 65+ years. Enrolment: 360.
Status: Authorised, recruitment pending. Decision date: 2026-05-18. Results received: No. Last updated: 2026-05-18.

Condition(s): Neisseria gonorrhoeae Infections
Product: CEFTRIAXONE, TEMOCILLIN, Negaban 2 g poudre pour solution injectable/pour perfusion

Primary endpoint: Proportion of participants with therapeutic success at D21. Therapeutic success is defined by a negative PCR for Ng at all three sites (urine/vagina, throat and anus) at D21 of treatment.
Endpoint(s): - Proportion of participants with therapeutic success at D21 according to each infected site urine/vagina, throat or anus). Therapeutic success is defined by a negative PCR for the infection site at day 21 of treatment., - Incidence of clinical and biological adverse effects (AEs), grade 3 or 4 AEs, all-grade AEs, treatment-related adverse events (all grades), study discontinuations due to AEs, and serious adverse events at M3., - Satisfaction/perception evaluated by the patient at baseline (D1, after injection) and D21 (5 questions asked during consultation), - Proportion of ESBL-E rectal colonization at baseline (D1), D21, and M3, - Composition of the throat/anal and urine/vagina microbiota at D1, D21 and M3, - Ng populations, clonality, and analysis of resistance determinants (MIC, ST, resistance genes) at day 1 and D21.

Source: https://euclinicaltrials.eu/ctis-public/view/2025-524475-23-00